EU clinical trial 2024-519215-33-00: A Study to Learn How Different Amounts of the Study Medicine Called PF-07985631 are Tolerated and Act in the Body in Healthy Adults
Protocol code: C5661001
Sponsor: Pfizer Inc. (Pharmaceutical company). Phase: Human Pharmacology (Phase I)- First administration to humans. Countries: Belgium (ongoing, recruitment ended).
Therapeutic area(s): Diseases [C] - Immune System Diseases [C20]
Gender: Female, Male. Age: 18-64 years. Enrolment: 92.
Status: Ongoing, recruitment ended. Start date (EU): 2025-08-07. Decision date: 2025-07-01. Results received: No. Last updated: 2026-06-05.

Condition(s): IgA nephropathy

Source: https://euclinicaltrials.eu/ctis-public/view/2024-519215-33-00